EU clinical trial 2024-515609-25-00: A dose optimization study for L19TNF in combination with lomustine in patients with glioblastoma at progression or recurrence
Protocol code: PH-L19TNFLOM-01/23
Sponsor: Philogen S.p.A. (Pharmaceutical company). Phase: Therapeutic exploratory (Phase II). Countries: Germany (not authorised), Italy (not authorised).
Therapeutic area(s): Diseases [C] - Neoplasms [C04]
Gender: Female, Male. Age: 18-64 years, 65+ years. Enrolment: 20.
Status: Not authorised. Decision date: 2024-12-04. Results received: No. Last updated: 2024-12-09.
Decision dates by country: DE: 2024-12-04, IT: 2024-12-09

Condition(s): Glioblastoma
Product: Lomustine "medac" 40 mg, Fibromun

Primary endpoint: Safety endpoints: Incidence of adverse Events (AEs), Serious Adverse Events (SAEs) and Drug-Induced Liver Injury (DILI), standard labor-atory assessments, ECG, ECHO and physical examination ac-cording to CTCAE v.5.0, Efficacy endpoint: Survival rate at 12 months
Endpoint(s): Progression-Free Survival (PFS), Overall Survival (OS), Objective Response Rate (ORR), Disease Control Rate (DCR), Duration of Response (DoR), Incidence of Dose Reductions, Incidence of Dose Modifications, Pharmacokinetic parameters of L19TNF, Assessment of the formation of Human Anti-Fusion protein Antibodies (HAFA) against L19TNF

Source: https://euclinicaltrials.eu/ctis-public/view/2024-515609-25-00